EU clinical trial 2024-520320-28-00: Echo-guided scalp blocks and incidence of postoperative pain in scheduled supratentorial intracranial surgery - ULTRASCALP
Protocol code: CHUBX 2023/42
Sponsor: Centre Hospitalier Universitaire De Bordeaux (Hospital/Clinic/Other health care facility). Phase: Phase III and phase IV (Integrated). Countries: France (authorised, recruitment pending).
Therapeutic area(s): Analytical, Diagnostic and Therapeutic Techniques and Equipment [E] - Anesthesia and Analgesia [E03]
Gender: Female, Male. Age: 18-64 years, 65+ years. Enrolment: 230.
Status: Authorised, recruitment pending. Decision date: 2025-06-11. Results received: No. Last updated: 2025-06-11.

Condition(s): supratentorial intracranial surgery with flap creation
Product: XYLOCAINE 10 mg/ml ADRENALINE 0,005 mg/ml, solution injectable, ROPIVACAINE KABI 2 mg/ml, solution injectable en ampoule., MORPHINE, PARACETAMOL B. BRAUN 10 mg/ml, solution pour perfusion

Primary endpoint: Composite criterion of occurrence of events involving : - Either the need for morphine titration at a dosage greater than 0.05 mg.kg-1 in the immediate postoperative period (i.e., up to 6 h after extubation). - or the existence of severe pain defined by a numerical scale episode > 4 in the immediate post-operative period (i.e. up to 6 hours after extubation).
Endpoint(s): ANI will be collected after induction, at the time of intubation, at the time of placement of the Mayfield frame and at the time of incision. Doses of hypnotic (propofol) and analgesic (remifentanil) will be recorded at these times., The numerical pain assessment scale will also be collected hourly up to 6 hours after extubation and at 24 hours post-operatively by the nurses in the continuous monitoring unit., The amount of morphine consumed on an hourly basis up to 6 hours after extubation and at 24 hours post-operatively will be collected using the computerized chart in the continuous care unit., The occurrence of post-operative nausea and vomiting will also be collected and defined by at least one of the following: the presence of nausea / the need for rescue antiemetic treatment / at least one episode of vomiting. This criterion is collected at 6 and 24 hours post-operatively on the basis of the data on the placard, and assessed by the nurses in the continuous monitoring unit in accordance with departmental practice., The presence of a persistent headache at 3 months post-op, not attributable to another cause, will be collected by telephone interview. The numerical scale of this headache, if any, the DN4 score and the need to take level 2 or 3 analgesics to treat this pain will also be collected in a declarative manner by telephone by an investigator blinded to the treatment group., The occurrence of surgical site infection will be collected at 3 months post-op., The number of nerves that may have been blocked by ultrasound for each patient will be collected at the time the scalp blocks are made by the practitioner performing them. The approach will also be recorded.

Source: https://euclinicaltrials.eu/ctis-public/view/2024-520320-28-00